EU clinical trial 2023-504153-12-00: A Phase II, Open-label, Multi-center, Basket Study of the ATR Kinase Inhibitor ART0380 Administered Orally as Monotherapy to Patients with Biologically Selected Advanced or Metastatic Solid Tumors (ARTIST)
Protocol code: ART0380C004
Sponsor: Artios Pharma Limited (Pharmaceutical company). Phase: Therapeutic exploratory (Phase II). Countries: France (ended), Spain (ended).
Therapeutic area(s): Diseases [C] - Neoplasms [C04]
Gender: Female, Male. Age: 18-64 years, 65+ years. Enrolment: 40.
Status: Ended. Start date (EU): 2023-12-07. End date (EU): 2025-05-26. End date: 2025-05-27. Decision date: 2023-11-02. Results received: Yes. Last updated: 2025-06-16.
Decision dates by country: ES: 2023-11-06, FR: 2023-11-02

Condition(s): Advanced or Metastatic Solid Tumors

Primary endpoint: Objective Response Rate (ORR).
Endpoint(s): Incidence and severity of AEs, Progression free survival (PFS), best overall response (BOR), disease control rate (DCR), duration of response (DOR) and change in tumor size (based on RECIST v1.1). Overall survival (OS, collected until the time of data cut-off)., Plasma concentration data.

Source: https://euclinicaltrials.eu/ctis-public/view/2023-504153-12-00